EU clinical trial 2024-513255-32-00: [18F]FAPI-PET/CT and Laparoscopy in STagIng advanced gastric Cancer – a multicenter prospective study (PLASTIC-3-study)
Protocol code: 134826
Sponsor: Leids Universitair Medisch Centrum (LUMC) (Hospital/Clinic/Other health care facility). Phase: Phase II and Phase III (Integrated). Countries: Netherlands (ongoing, recruiting).
Therapeutic area(s): Diseases [C] - Neoplasms [C04]; Analytical, Diagnostic and Therapeutic Techniques and Equipment [E] - Diagnosis [E01]; Diseases [C] - Digestive System Diseases [C06]
Gender: Female, Male. Age: 18-64 years. Enrolment: 250.
Status: Ongoing, recruiting. Start date (EU): 2025-07-03. Decision date: 2025-05-06. Results received: No. Last updated: 2025-12-03.

Condition(s): Advanced gastric cancer
Product: [18F]-AlF-FAPI-74

Primary endpoint: Proportion of patients in whom [18F]AlF-FAPI-74 PET/CT leads to detection of M1-disease resulting in change in treatment intent determined by the local multidisciplinary team (MDT) meetings, including: the number of prevented unnecessary surgeries (staging laparoscopies and/or gastrectomies) and the number of changes from curative to palliative treatment, Proportion of patients in whom [18F]AlF-FAPI-74 PET/CT leads to changes in diagnostic work-up determined by the local MDT meetings, including: the number of additional biopsies or longitudinal imaging and the number of changes in extent of surgery
Endpoint(s): Diagnostic performance measured in sensitivity, specificity, diagnostic accuracy, positive predictive value and negative predictive value using histopathologic tumor tissue collected during biopsy, staging laparoscopy and follow-up imaging as refence test, Proportion of patients with relevant incidental findings (e.g. second primary tumors), Patients’ extra burden of undergoing additional diagnostics due to incidental and/or non-specific [18F]AlF-FAPI-74 PET/CT findings using EORTC-QLQ-C30, EQ-5D-5L, and patient reported experience measure (PREM) questionnaires (section 6.1), Time between pre-diagnostic and post-diagnostic MDT meetings, The occurrence, type, and severity of (serious) adverse events, Correlation between 18F]AlF FAPI 74 PET based Peritoneal Cancer Index (PCI) scores and staging laparoscopy based PCI scores as a reference standard for ‘true’ intraperitoneal tumor load, Correlation between PCI-regional FAPI uptake and PCI-regional histopathological tumor scores, Expression of CAF content as measured by tumor-stroma ratio (TSR) on tissue samples from D1D2/CRITICS and relation with FAP expression., Analysis of TSR and FAP expression and correlation to [18F]AlF-FAPI-74 PET/CT signal, Analysis of all FAP expressing CAF subsets in obtained patient samples using imaging mass cytometry, Patient burden using a developed patient reported experience measure (PREM) questionnaire, Quality of life as measured using the EORTC-QLQ-C30 and EQ-5D5L questionnaires and compared to PLASTIC, Costs of [18F]AlF- FAPI-74 PET/CT compared with staging laparoscopy compared to PLASTIC for patients who received SL only, using the SL bottom-costing approach numbers from the PLASTIC-cost analysis study

Source: https://euclinicaltrials.eu/ctis-public/view/2024-513255-32-00